EU clinical trial 2025-523892-50-00: A Randomized Open Label Trial Exploring the Soluble and Imaging Biomarker Dynamic Responses to Tolebrutinib Compared to Rituximab Treatment in Patients with Multiple Sclerosis (MS)
Protocol code: MSBenefiT
Sponsor: Region Stockholm – SLSO (Hospital/Clinic/Other health care facility). Phase: Therapeutic confirmatory (Phase III). Countries: Sweden (authorised, recruitment pending).
Therapeutic area(s): Diseases [C] - Nervous System Diseases [C10]
Gender: Female, Male. Age: 18-64 years, 65+ years. Enrolment: 60.
Status: Authorised, recruitment pending. Decision date: 2026-06-02. Results received: No. Last updated: 2026-06-02.

Condition(s): Multiple Sclerosis
Product: Tolebrutinib, RITUXIMAB

Primary endpoint: Relative change from baseline in CSF NfL at 12 months
Endpoint(s): Serum NfL at 12 and 24 months, CSF and serum GFAP at 12 and 24 months, CSF biomarkers of chemokines (CXCL10, CXCL13), innate immuny (LCN2, CHIT1), complement system (C1QA, C5), and synapses (SNAP25, SV2A) at 12 months

Source: https://euclinicaltrials.eu/ctis-public/view/2025-523892-50-00